EU clinical trial 2024-511752-40-00: A Double-Masked, Randomized, Placebo-Controlled, Parallel-Group, 12-Week Administration With Two-Week Gradual Dose Taper Phase and 38-Week Follow-Up Phase, Phase 3 Study to Investigate the Safety and Efficacy of Ripasudil (K-321) Eye Drops After Descemetorhexis in Subjects with Fuchs Endothelial Corneal Dystrophy
Protocol code: K-321-301
Sponsor: Kowa Research Institute Inc. (Laboratory/Research/Testing facility). Phase: Therapeutic confirmatory (Phase III). Countries: Denmark (ended), Spain (ended), Germany (ended).
Therapeutic area(s): Diseases [C] - Eye Diseases [C11]
Gender: Female, Male. Age: 18-64 years, 65+ years. Enrolment: 27.
Status: Ended. Start date (EU): 2023-05-05. End date (EU): 2026-01-28. End date: 2026-02-20. Decision date: 2024-05-28. Results received: No. Last updated: 2025-03-19.
Decision dates by country: DK: 2024-05-28, ES: 2024-05-29, DE: 2024-05-28

Condition(s): Fuchs Endothelial Corneal Dystrophy
Product: A matching sterile product (Placebo Ophthalmic Solution) will be provided using the same excipient formulation as the active K-321 product., Ripasudil

Primary endpoint: Time to ≥40 ETDRS letter improvement in BCVA during the first 12 weeks after descemetorhexis.
Endpoint(s): Key secondary endpoints: • Time to ≥20 ETDRS letter improvement during the first 12 weeks after descemetorhexis. • Time to achievement of ≥70 ETDRS letters during the first 12 weeks after descemetorhexis. • Central corneal ECD change from baseline at Week 12. • Time to achievement of no corneal edema in both areas (epithelial, stromal) during the first 12 weeks after descemetorhexis. • Time to exceed pre-DSO ETDRS letter score in BCVA during the first 12 weeks after descemetorhexis.

Source: https://euclinicaltrials.eu/ctis-public/view/2024-511752-40-00